EU clinical trial 2024-516758-23-00: A randomized, double-blind, placebo-controlled dose-finding study of 0.05%, 0.025%, 0.01% and 0.005% atropine eye drops to inhibit myopia progression in children in a European population
Protocol code: PSt012021
Sponsor: Pharma Stulln GmbH (Pharmaceutical company). Phase: Therapeutic exploratory (Phase II). Countries: Germany (ended).
Therapeutic area(s): Diseases [C] - Eye Diseases [C11]
Gender: Female, Male. Age: 0-17 years. Enrolment: 135.
Status: Ended. Start date (EU): 2022-09-19. End date (EU): 2025-04-15. Decision date: 2024-09-02. Results received: Yes. Last updated: 2024-12-09.
Decision dates by country: DE: 2024-09-19

Condition(s): Myopia progression in children
Product: Atropine Sulfate 0.025% Eye Drops, solution in single-dose container, Atropine Sulfate 0.005% Eye Drops, solution in single-dose container, Placebo Atropine Sulfate Eye Drops, solution in single-dose container, Atropine Sulfate 0.01% Eye Drops, solution in single-dose container, Atropine Sulfate 0.05% Eye Drops, solution in single-dose container

Primary endpoint: The primary efficacy endpoint is the change of myopia determined by the spherical equivalent measured by autorefractor measurement with cycloplegia in the following 12 months after the beginning of low dose atropine treatment.
Endpoint(s): The secondary efficacy endpoints are the changes in - Axial eye growth - Anterior chamber depth - IOL-power for Spheris 209 - Lens thickness - Pupil size under photopic and scotopic conditions - Accommodation - Best corrected visual acuity and distance corrected near visual acuity - Atropine effects as a function of iris pigmentation in the course of 12 months of low dose Atropine treatment., Safety: Change from Baseline to Day 365 in: - IOP - Appearance of the macula Incidence of - Local adverse drug reactions - Systemic adverse drug reactions as assessed by the subject/caregiver. Incidence of adverse events assessed by investigator

Source: https://euclinicaltrials.eu/ctis-public/view/2024-516758-23-00